EU clinical trial 2024-517965-18-00: Additional chemotherapy for EGFRm patients with the continued presence of plasma ctDNA EGFRm at week 3 after start of osimertinib 1st-line treatment (PACE-Lung)
Protocol code: PACE-LUNG
Sponsor: Goethe University Frankfurt (Educational Institution). Phase: Therapeutic exploratory (Phase II). Countries: Germany (ongoing, recruitment ended).
Therapeutic area(s): Diseases [C] - Respiratory Tract Diseases [C08]
Gender: Female, Male. Age: 18-64 years, 65+ years. Enrolment: 400.
Status: Ongoing, recruitment ended. Start date (EU): 2021-11-11. Decision date: 2024-10-25. Results received: No. Last updated: 2026-01-21.

Condition(s): Advanced NSCLC with common EGFR-Mutation
Product: TAGRISSO 80 mg film-coated tablets, CISPLATIN, PEMETREXED, CARBOPLATIN, TAGRISSO 40 mg film-coated tablets

Primary endpoint: Progression Free Survival (PFS1) using investigator assessments according to Response Evaluation Criteria in Solid Tumours (RECIST 1.1) defined as number of months from first dose of chemotherapy until last follow-up, PD, death or withdrawal of consent

Source: https://euclinicaltrials.eu/ctis-public/view/2024-517965-18-00